EU clinical trial 2023-505627-30-00: An Open-label, Dose Escalation, Phase 1/2 Study to Evaluate the Safety, Tolerability, Pharmacokinetics, and Pharmacodynamics of TAK-676 as a Single Agent and in Combination With Pembrolizumab in Adult Patients With Advanced or Metastatic Solid Tumors
Protocol code: TAK-676-1002
Sponsor: Takeda Development Center Americas Inc. (Pharmaceutical company). Phase: Phase I and Phase II (Integrated)- First administration to humans. Countries: Poland (ended), France (ended), Austria (ended), Belgium (ended).
Therapeutic area(s): Diseases [C] - Neoplasms [C04]
Gender: Female, Male. Age: 18-64 years, 65+ years. Enrolment: 114.
Status: Ended. Start date (EU): 2023-07-26. End date (EU): 2026-03-30. End date: 2026-03-31. Decision date: 2024-06-03. Results received: No. Last updated: 2025-07-18.
Decision dates by country: PL: 2024-06-05, AT: 2024-06-04, BE: 2024-06-04, FR: 2024-06-03

Condition(s): Solid Neoplasm
Product: CISPLATIN, CARBOPLATIN, KEYTRUDA 25 mg/mL concentrate for solution for infusion, CISPLATIN, FLUOROURACIL

Primary endpoint: Frequency and severity of TEAEs., Number of patients with DLTs., Number and percentage of patients with 1 or more treatment-emergent SAE., Number and percentage of patients with 1 or more TEAE leading to dose modifications and treatment discontinuation., Safety endpoints will be evaluated according to the (NCI CTCAE), Version 5.0.
Endpoint(s): Dose escalation, Japan safety lead-in, and expansion phases:, Response assessments per (RECIST) v.1.1 (Eisenhauer et al. 2009) by investigator – ORR ([cCR] + [cPR])., Response assessments per (RECIST) v.1.1 (Eisenhauer et al. 2009) by investigator. DCR (cCR + cPR + [SD] >6 weeks)., Response assessments per (RECIST) v.1.1 (Eisenhauer et al. 2009) by investigator. DOR., Response assessments per (RECIST) v.1.1 (Eisenhauer et al. 2009) by investigator. TTR., Expansion phase only: Response assessments per RECIST v.1.1 by investigator – PFS, Response assessments per RECIST v.1.1 by investigator. OS, Response assessments per RECIST v.1.1 by investigator. OS rate at 12 months, Response assessments per RECIST v.1.1 by investigator. OS rate at 6 months

Source: https://euclinicaltrials.eu/ctis-public/view/2023-505627-30-00